EU clinical trial 2023-506317-22-00: The Sahlgrenska Anti-VEGF (SAHLVE) Study - a Prospective Randomized Double-blind Comparison of Bevacizumab and Aflibercept in Patients With Neovascular Age-related Macular Degeneration
Sponsor: Vaestra Goetalandsregionen (Hospital/Clinic/Other health care facility). Phase: Therapeutic exploratory (Phase II). Countries: Sweden (ongoing, recruitment ended).
Therapeutic area(s): Diseases [C] - Eye Diseases [C11]
Gender: Female, Male. Age: 18-64 years, 65+ years. Enrolment: 402.
Status: Ongoing, recruitment ended. Start date (EU): 2019-09-18. Decision date: 2023-08-30. Results received: No. Last updated: 2023-08-30.

Condition(s): Neovascular (wet) age-related macular degeneration (AMD)
Product: Avastin 25 mg/ml concentrate for solution for infusion., Eylea 40 mg/mL solution for injection in a vial

Primary endpoint: Number of intravitreal injections after two years
Endpoint(s): Best-corrected visual acuity (BCVA), distance ETDRS and near LIX., Macular thickness (Central Retinal Thickness; CRT, in μm., Intraocular pressure (IOP) mmHg., Recurrence interval (maximum number of weeks from last injection to relapse), at first and last relapse., Durability (longest inactive interval detected, in number of weeks)., Cost efficiency: Quality-adjusted life years (QALY), cost-per-QALY is measured with the EuroQol-5 Dimension (EQ-5D) questionnaire., Vision-related quality of life (NEI VFQ-25)., Cost-benefit analysis: The incremental cost-effectiveness ratio (ICER).

Source: https://euclinicaltrials.eu/ctis-public/view/2023-506317-22-00